EU clinical trial 2025-524768-39-00: The pilot bioavailability study comparing the absorption of carbetocin (which is used as prevention of heavy bleeding after childbirth) in PABAL 100 μg/mL Solution for Injection when administered sublingually in the dose of 500 μg and intramuscularly in the dose of 100 μg.
Protocol code: 1067/25
Sponsor: Oxytone Bioscience B.V. (Pharmaceutical company). Phase: Human Pharmacology (Phase I)- Bioequivalence Study. Countries: Czechia (ended).
Therapeutic area(s): Diseases [C] - Female Urogenital Diseases and Pregnancy Complications [C13]
Gender: Female. Age: 18-64 years. Enrolment: 4.
Status: Ended. Start date (EU): 2026-03-13. End date (EU): 2026-03-25. Decision date: 2026-02-09. Results received: No. Last updated: 2026-03-03.

Condition(s): Not applicable (submitted trial is a bioavalability study in healthy participants).

Source: https://euclinicaltrials.eu/ctis-public/view/2025-524768-39-00